EU clinical trial 2024-516874-31-00: Letrozole for Estrogen/Progesterone Receptor positive low-grade serous Epithelial ovarian cancer. A randomized phase III trial. LEPRE Trial
Protocol code: 10UCS2018
Sponsor: Ente Ospedaliero Ospedali Galliera Di Genova (Hospital/Clinic/Other health care facility). Phase: Therapeutic confirmatory (Phase III). Countries: Italy (ongoing, recruiting), Czechia (authorised, recruitment pending).
Therapeutic area(s): Diseases [C] - Neoplasms [C04]
Gender: Female. Age: 18-64 years, 65+ years. Enrolment: 142.
Start date (EU): 2024-12-10. Decision date: 2024-12-09. Results received: No. Last updated: 2026-04-08.
Decision dates by country: CZ: 2026-04-08, IT: 2024-12-09

Condition(s): Patients with a low-grade serous epithelial carcinoma of the ovary (LGSCO) including cancer of fallopian tube and peritoneum, FIGO III-IV stage and with ER+ and/or PgR+ after primary surgery are eligible.
Product: Letrix 2,5 mg compresse rivestite con film., CARBOPLATIN, PACLITAXEL

Primary endpoint: The primary endpoint is PFS, defined for each patient as the time from the date of randomization to the date of local or regional relapse, distant metastasis, or death from any cause, whichever comes first.
Endpoint(s): Objective Response Rate (ORR), defined as the percentage of patients with an objective response determined by a complete response (CR) or a partial response (PR) as determined by RECIST 1.1.

Source: https://euclinicaltrials.eu/ctis-public/view/2024-516874-31-00